EU clinical trial 2024-518352-23-00: Evaluation of metformin effect on the fertility of women treated with 131I for thyroid cancer
Protocol code: 2020/ABM/01/00100
Sponsor: Medical University Of Bialystok (Educational Institution). Phase: Therapeutic confirmatory (Phase III). Countries: Poland (ongoing, recruiting).
Therapeutic area(s): Diseases [C] - Neoplasms [C04]
Gender: Female. Age: 18-64 years. Enrolment: 160.
Status: Ongoing, recruiting. Start date (EU): 2022-11-09. Decision date: 2024-12-03. Results received: No. Last updated: 2025-11-18.

Condition(s): papillary thyroid carcinoma
Product: GLUCOPHAGE 500 mg tabletki powlekane, Placebo

Primary endpoint: The primary endpoint will be to evaluate the effect of metformin on the difference in serum AMH, inhibin B and FSH concentration and the number of antral follicles, assessed in the study groups consisted of the women with papillary thyroid cancer, treated with 131I, comparing received results during the randomized, V3, V4, V5 and V6 visits.
Endpoint(s): To evaluate the metformin modulating impact on the concentrations of selected parameters of oxidative stress assessed in the study groups consisted of the women with papillary thyroid cancer, treated with 131I, comparing received results during the randomized, V3, V4, V5 and V6 visits., To evaluate the effect of metformin on the difference in serum concentration of selected parameters of apoptosis between the study groups in women with papillary thyroid cancer, treated with 131I, comparing received results during the randomized, V3, V4, V5 and V6 visits, To evaluate the effect of metformin on the difference of expression in selected microRNA between the study groups in women with papillary thyroid cancer, treated with 131I, between the randomized visit and V3, V4, V5 and V6 visit, Assessment of the quality of life using the QLQ-THY34 questionnaire dedicated to patients with thyroid cancer., Characteristics and tolerability of standard metformin dosage in patient with papillary thyroid cancer., Frequency of AEs requiring discontinuation of study drug or dose reduction., Change in basic laboratory assessment between visits.

Source: https://euclinicaltrials.eu/ctis-public/view/2024-518352-23-00